EU clinical trial 2025-523692-39-00: Multicentre, open-label, randomised, controlled, parallel-arms, phase III, clinical trial of Neoadjuvant FOLFOXIRI and Chemoradiotherapy versus Neoadjuvant CAPOX/FOLFOX and Chemoradiotherapy, followed by Surgery or a Watch-and-Wait Approach in High Risk Locally Advanced Rectal Cancer: MEND-IT II
Sponsor: Catharina Ziekenhuis Stichting (Hospital/Clinic/Other health care facility). Phase: Therapeutic confirmatory (Phase III). Countries: Netherlands (ongoing, recruiting).
Therapeutic area(s): Diseases [C] - Neoplasms [C04]
Gender: Female, Male. Age: 18-64 years, 65+ years. Enrolment: 394.
Status: Ongoing, recruiting. Start date (EU): 2026-03-11. Decision date: 2026-02-04. Results received: No. Last updated: 2026-06-04.

Condition(s): locally advanced rectal cancer
Product: Oxaliplatin Eugia 5 mg/ml concentraat voor oplossing voor infusie, Folinic acid (as calcium folinate) 10 mg/ml solution for injection/infusion, Fluorouracil Accord 50 mg/ml otopina za injekciju/infuziju, Irinotecan Hydrochloride medac 20 mg/ml, concentrate for solution for infusion.

Primary endpoint: pCR post operatively: The pathological response is evaluated by an experienced pathologist in one of the participating centres and noted in the patient’s medical file. A pathological complete response is defined as the absence of residual tumour cells in the complete resected specimen including all resected regional lymph nodes (ypT0N0) according to the 8th edition of the UICC TNM classification of malignant tumours., cCR at 1 year: The clinical response is evaluated by an experienced radiologist in one of the participating centres and noted in the patients’ medical file. A cCR is defined as the absence of viable tumour tissue based on magnetic resonance imaging and endoscopic evaluation. In case of a sustained cCR at 1 year, there is no regrowth or viable tumour tissue present on magnetic resonance imaging and endoscopy 1 year after the last day of chemoradiotherapy.
Endpoint(s): Regrowth free survival at 3 and 5 years. Regrowth is defined as endoluminal or locoregional nodal recurrence after cCR in a watch and wait approach., Local recurrence free survival at 3 and 5 years. Local recurrence is defined as locoregional recurrence after TME-surgery. Local recurrence is confirmed by either radiological or histopathological examination., Distant metastasis free survival at 3 and 5 years. Distant metastasis is confirmed by either radiological or histopathological examination., Progression free survival at 3 and 5 years. Progression is defined as progression of the primary tumour, local recurrence or distant metastases, confirmed by radiological or histopathological examination or death., Disease free survival (DFS) at 3 and 5 years. DFS is defined as no confirmed signs of local recurrence, distant metastases or death., Overall survival at 3 and 5 years., Successful organ preservation at 1 and 3 years. Organ preservation is considered to have failed if the rectum is removed; if the patient develops an unequivocal locoregional cancer recurrence or if the patient has a stoma., Radiological response after induction chemotherapy. Assessment and reporting of all MRI scans is performed by the radiologist according to a standard operating procedure and is registered in the patient’s medical file., Radiological response after chemoradiotherapy. Assessment and reporting of all MRI scans is performed by the radiologist according to a standard operating procedure and is registered in the patient’s medical file., Pathological response as determined by Mandard grading system. The Mandard score is registered by the pathologist in the patient's medical file., Toxicity related to induction chemotherapy, graded according to the NCI Common Terminology Criteria for Adverse Events (CTCAE) v5.0. Toxicity related to induction chemotherapy will be scored from day one of the first cycle until one month after the last administration of induction chemotherapy and is registered in the patient’s medical file by the treating oncologist. All CTCAE grade ≥ 2 and haematological CTCAE ≥ 3 AEs are registered., Compliance related to induction chemotherapy. Information on compliance to treatment is registered by the treating oncologist in the patient's medical file., Toxicity related to chemoradiotherapy according to the NCI Common Terminology Criteria for Adverse Events (CTCAE) v5.0. Toxicity caused by chemoradiotherapy will be scored from start of radiotherapy until 3 months after the last administration of the radiotherapy and is registered in the patient’s medical file by the treating radiation oncologist or medical oncologist. All non-haematological CTCAE grade ≥ 2 and haematological CTCAE ≥ 3 AEs are registered., Compliance related to chemoradiotherapy. Information on compliance to treatment is registered by the treating radiotherapist or oncologist in the patient's medical file., Dose reductions during induction chemotherapy are registered by the treating oncologist. The treating oncologist will record the cycle in which the dose reduction takes place and the agent for which the dose is reduced. When a dose reduction is required, the reason for dose reduction will be recorded in the patient's medical file., Dose reductions during chemoradiotherapy. The treating oncologist will record a dose reduction regarding capecitabine or Teysuno. The radiation oncologist will record a dose reduction regarding radiotherapy. When dose reduction is required, the reason for dose reduction will be recorded in the patient's medical file., Completion rate of induction chemotherapy: this is calculated as a percentage from the total number of patients per group., Completion rate of chemoradiotherapy: this is calculated as a percentage from the total number of patients per group., Surgical characteristics: data on the surgical procedure are registered in the surgical report in the patient’s medical file by the operating surgeon. Data on intraoperative radiotherapy, if administered, are registered in the patient’s medical file by the radiation oncologist., Post-operative complications: data on postoperative complications, graded according to the Clavien-Dindo grading system, are registered in the patient’s medical file by the treating physician up to 3 months after surgery., Quality of life questionnaires at baseline, after ICT, after CRT, 3 months, 12 months and 24 months post operatively or after entering a W&W approach. Validated quality of life questionnaires are used: QLQ-C30, QLQ-CR29, EQ-5D-5L, QLQ-CIPN-20, Work productivity questionnaires: WPAI-GH questionnaire at baseline, after ICT and after CRT., Cost-effectiveness: the EQ-5D-5L questionnaire is used at baseline, and 12 months post-operatively.

Source: https://euclinicaltrials.eu/ctis-public/view/2025-523692-39-00